EU clinical trial 2024-516893-31-01: EVALUATION OF THE EFFICACY AND SAFETY OF SUBCUTANEOUS IMMUNOTHERAPY (BELTAVAC®) WITH POLYMERIZED ALLERGENIC EXTRACT OF HOUSE DUST MITE MIXTURE IN PATIENTS WITH ALLERGIC RHINITIS/RHINOCONJUNCTIVITIS
Protocol code: PRO-RCT-ACAROS-2018
Sponsor: Probelte Pharma S.L. (Pharmaceutical company). Phase: Therapeutic confirmatory (Phase III). Countries: Spain (ongoing, recruiting).
Therapeutic area(s): Diseases [C] - Disorders of Environmental Origin [C21]; Diseases [C] - Eye Diseases [C11]
Gender: Female, Male. Age: 0-17 years, 18-64 years. Enrolment: 250.
Status: Ongoing, recruiting. Start date (EU): 2022-01-31. Decision date: 2024-10-18. Results received: No. Last updated: 2024-10-18.

Condition(s): Allergic rhinoconjunctivitis due to exposure of house dust mites
Product: Beltavac Polymerized placebo. It is a saline solution without the allergenic extract, BELTAVAC with polymerized extract From Dermatophagoides

Primary endpoint: Score on the combined scale of nasal symptoms and specific medication (CSMS4) of allergy completed by the patient daily in his/her online patient card in periods of 4 weeks repeatedly during the year of follow-up.
Endpoint(s): - Nasal symptom scale score (SS4). - Specific medication scale score (MS). - Nasal and ocular symptom scale score (SS6) - Combined nasal, ocular symptom and medication scale score (CSMS6). - Percentage of days without symptoms or medication.

Source: https://euclinicaltrials.eu/ctis-public/view/2024-516893-31-01